EU clinical trial 2022-500215-39-00: A Phase 2 Randomized, Double-blind, Placebo-controlled Study of the Effect of EDG-5506 on Biomarker Response to Exercise in Adults with Becker Muscular Dystrophy, McArdle Disease, or Limb-Girdle Muscular Dystrophy
Protocol code: EDG-5506-202
Sponsor: Edgewise Therapeutics Inc. (Pharmaceutical company). Phase: Therapeutic exploratory (Phase II). Countries: Denmark (ended).
Therapeutic area(s): Diseases [C] - Musculoskeletal Diseases [C05]
Gender: Female, Male. Age: 18-64 years, 65+ years. Enrolment: 21.
Status: Ended. Start date (EU): 2022-12-06. End date (EU): 2025-11-24. End date: 2025-11-25. Decision date: 2022-10-12. Results received: No. Last updated: 2025-09-19.

Condition(s): McArdle Disease, Limb-Girdle Muscular Dystrophy, Becker Muscular Dystrophy
Product: EDG-5506, Test IMP (EDG-5506) without active substance

Primary endpoint: Incidence, frequency, and severity of adverse events and serious adverse events in those treated with EDG-5506 or placebo., Change in serum creatine kinase (CK) from baseline to week 16.
Endpoint(s): Change in serum CK from pre-exercise baseline to week 52., Incidence of treatment-emergent abnormal laboratory test results (clinical chemistry, hematology, and urinalysis). Change from Baseline in: - Safety laboratory parameters - Vital signs - Physical and neurological examination - Electrocardiogram (ECG) parameters - Cardiac function as assessed by echocardiogram - Pulmonary function as assessed by spirometry (FEV1,FVC) - C-SSRS (Columbia Suicide Severity Rating Scale), Steady state plasma concentrations of sevasemten

Source: https://euclinicaltrials.eu/ctis-public/view/2022-500215-39-00